EU clinical trial 2022-502889-24-00: Prospective, placebo-controlled clinical trial with Aconite Pain Oil in oncological patients undergoing chemotherapy to prevent chemotherapy-induced polyneuropathy (CIPN), to reduce symptoms typical of CIPN and to improve the quality of life of patients with CIPN
Protocol code: kp-acs-2
Sponsor: Wala-Heilmittel GmbH (Pharmaceutical company). Phase: Therapeutic confirmatory (Phase III). Countries: Germany (ongoing, recruiting).
Therapeutic area(s): Diseases [C] - Nervous System Diseases [C10]
Gender: Female, Male. Age: 18-64 years, 65+ years. Enrolment: 350.
Status: Ongoing, recruiting. Start date (EU): 2024-02-13. Decision date: 2023-10-12. Results received: No. Last updated: 2026-07-09.

Condition(s): chemotherapy-induced polyneuropathy (CIPN)
Product: Refined Peanut Oil, Aconit Schmerzöl

Primary endpoint: The primary endpoint is defined as time to occurence of CIPN. The effect of verum versus placebo is analysed using a COX regression model with the stratification variables of randomisation included as a covariate in the model. The following hypothesis is tested: H0: HR ≥ 1 vs. H1: HR < 1.
Endpoint(s): Time to occurrence of CIPN grade III (days) (COX regression model), Regression of CIPN that occurred during chemotherapy after discontinuation of chemotherapy by continued use of verum (degree of CIPN) (descriptively presented and exploratory statistical testing), No occurrence of CIPN after discontinuation of chemotherapy by continued use of verum (occurrence/no occurrence) (descriptively presented and exploratory statistical testing), Thermoception over the time (descriptively presented and mixed logistic regression model), Tactile perception over the time (descriptively presented and mixed logistic regression model), Nociception over the time (descriptively presented and mixed logistic regression model), Pallaesthesia over the time (descriptively presented and mixed linear regression model), Fine motor skills over the time (descriptively presented), Hand strength over the time (compared to baseline and mixed logistic regression model), Standing on toes over the time (descriptively presented), Standing on heel over the time (descriptively presented), Standing on one leg over the time (descriptively presented), Achilles tendon reflex over time (descriptively presented and mixed linear regression model), Radius periost reflex over the time (descriptively presented and mixed linear regression model), Patellar reflex over the time (descriptively presented and mixed linear regression model), Triceps reflex over the time (descriptively presented and mixed linear regression model), Biceps reflex over the time (descriptively presented and mixed linear regression model), PainDETECT over the time (descriptively presented and mixed linear regression model), EORTC-QLQ-CIPN20 over the time(descriptively presented and mixed linear regression model), EORTC-QLQ-C30 over the time (descriptively presented and mixed linear regression model), Insomnia Severity Index over the time (descriptively presented and mixed linear regression model), Anxiety and depression over the time (descriptively presented and mixed linear regression model), Patient satisfaction over the time (descriptively presented and exploratory statistical testing), Events related to chemotherapy due to CIPN (descriptively presented), Medication regarding CIPN over the time (descriptively presented), Adverse events (SAEs, ADRs, SADRs) (descriptively presented), Time to occurrence of CIPN grade II or higher (days) (COX regression model)

Source: https://euclinicaltrials.eu/ctis-public/view/2022-502889-24-00